EU clinical trial 2025-521677-14-00: Randomized Multicentric Proof-of-Concept Phase 2 Trial Doravirine in the Early Outpatient Management of West Nile Virus Infection in Patients at Risk of Progression - DORICO Trial
Protocol code: DORICO
Sponsor: Azienda Socio Sanitaria Territoriale Degli Spedali Civili Di Brescia (Hospital/Clinic/Other health care facility). Phase: Therapeutic exploratory (Phase II). Countries: Italy (authorised, recruitment pending).
Therapeutic area(s): Diseases [C] - Virus Diseases [C02]
Gender: Female, Male. Age: 18-64 years, 65+ years. Enrolment: 50.
Status: Authorised, recruitment pending. Decision date: 2025-10-24. Results received: No. Last updated: 2026-03-05.

Condition(s): West Nile Virus Infection
Product: Pifeltro 100 mg film-coated tablets

Primary endpoint: To evaluate the percentage of patients in whom early treatment with Doravirine (DOR), administered to outpatients with West Nile Virus (WNV) infection and risk factors for progression, accelerates the 4-fold decline in viremia compared to the standard of care (SOC)
Endpoint(s): To evaluate the percentage of patients in whom early treatment with DOR, administered to outpatients with WNV infection and risk factors for progression, expedites the resolution of fever compared to SOC.

Source: https://euclinicaltrials.eu/ctis-public/view/2025-521677-14-00